EU clinical trial 2022-501946-31-00: A Phase 3, Multicenter, Randomized, Double-blind, Parallel-group, Safety and Efficacy Study of Linaclotide versus Placebo in Pediatric Subjects, Ages 2 to 5 Years, with Functional Constipation (FC) with a 24-week Open-label Treatment Extension
Protocol code: M21-572
Sponsor: Abbvie Deutschland GmbH & Co. KG (Pharmaceutical company). Phase: Therapeutic confirmatory (Phase III). Countries: Netherlands (ended), Bulgaria (ended).
Therapeutic area(s): Diseases [C] - Nutritional and Metabolic Diseases [C18]
Gender: Female, Male. Age: 0-17 years. Enrolment: 14.
Status: Ended. Start date (EU): 2024-02-29. End date (EU): 2025-06-30. End date: 2025-09-02. Decision date: 2023-08-07. Results received: Yes. Last updated: 2025-05-19.
Decision dates by country: BG: 2023-08-14, NL: 2023-08-07

Condition(s): Functional Constipation
Product: Linaclotide, Linaclotide Placebo

Primary endpoint: Change from baseline in 12-week SBM frequency rate (SBMs/week) observed by the primary caregiver during the double-blind study intervention period.
Endpoint(s): Change from baseline in 12-week stool consistency observed by the primary caregiver during the double-blind study intervention period, Change from baseline in 12-week straining observed by the primary caregiver during the double-blind study intervention period, Change from baseline in 12-week proportion of days with fecal incontinence during the double-blind study intervention period (for subjects who have acquired toileting skills during daytime and nighttime or acquired toileting skills during daytime only)

Source: https://euclinicaltrials.eu/ctis-public/view/2022-501946-31-00